EU clinical trial 2023-504908-28-01: Improvement of MRI assessed cerebral Perfusion and oxygenation by luspatercept-induced Anemia Correction in non-transfusion dependent Thalassemia
Sponsor: Amsterdam UMC (Hospital/Clinic/Other health care facility). Phase: Phase III and phase IV (Integrated). Countries: Netherlands (ongoing, recruiting).
Therapeutic area(s): Diseases [C] - Hemic and Lymphatic Diseases [C15]
Gender: Female, Male. Age: 18-64 years, 65+ years. Enrolment: 15.
Status: Ongoing, recruiting. Start date (EU): 2024-07-14. Decision date: 2023-11-17. Results received: No. Last updated: 2026-05-04.

Condition(s): Non-transfusion dependent beta-thalassmia
Product: Reblozyl 75 mg powder for solution for injection

Primary endpoint: Cerebral metabolic rate of oxygen (CMRO2) is measured by MRI technique by T2 relaxation under spin tagging (TRUST).
Endpoint(s): CBF will be measured by time-encoded CASL., Transthoracic echocardiography will be performed in order to assess the TRV. These assessments will be performed at baseline, and 27 weeks later. If transthoracic echocardiography to assess the TRV has been performed within one year before the first study visit (prior to inclusion of the patient in the study), that previously performed transthoracic echocardiography will be used as baseline transthoracic echocardiography for this study., General laboratory analysis will be performed on venous blood samples at baseline, every three weeks after start of treatment until week 27. Analysis consists of hemoglobin, leukocyte and platelet count, renal and liver assessments and NT-proBNP.

Source: https://euclinicaltrials.eu/ctis-public/view/2023-504908-28-01